EU clinical trial 2023-510431-11-00: FRONT-LINE VENETOCLAX AND OBINUTUZUMAB COMBINATION FOLLOWED BY VENETOCLAX OR VENETOCLAX AND ZANUBRUTINIB COMBINATION IN PATIENTS WITH RESIDUAL DISEASE: A MINIMAL RESIDUAL DISEASE (MRD) TAILORED TREATMENT FOR YOUNG PATIENTS WITH HIGH-RISK CLL. A phase 2 multicenter study (VIS trial) CLL2222
Sponsor: Fondazione Gimema Franco Mandelli Onlus (Patient organisation/association). Phase: Therapeutic exploratory (Phase II). Countries: Italy (ongoing, recruiting).
Therapeutic area(s): Diseases [C] - Hemic and Lymphatic Diseases [C15]
Gender: Female, Male. Age: 18-64 years. Enrolment: 78.
Status: Ongoing, recruiting. Start date (EU): 2023-07-21. Decision date: 2024-07-16. Results received: No. Last updated: 2026-07-20.

Condition(s): Chronic Lymphocytic Leukemia
Product: PARACETAMOL, CHLORPHENAMINE MALEATE, VENETOCLAX, ALLOPURINOL, Bactrim 160 mg + 800 mg compresse, VENETOCLAX, BRUKINSA 80 mg hard capsules, Lamivudina Mylan 150 mg compresse rivestite con film, DEXAMETHASONE PHOSPHATE, VENETOCLAX, Gazyvaro 1,000 mg concentrate for solution for infusion.

Primary endpoint: To evaluate in young CLL patients with an adverse biologic profile: 1. The benefit of front-line therapy with Venetoclax and Obinutuzumab (VenObi) in terms of rate of patients with uMRD by ASO-PCR in the PB and BM measured at the end of combination therapy (EOCT month 9)., To evaluate in young CLL patients with an adverse biologic profile: The benefit of adding Zanubrutinib to Venetoclax (VenZan) in terms of rate of patients with uMRD by ASO-PCR in the PB and BM in patients with residual disease at the EOCT with VenObi (month 21).
Endpoint(s): The benefit of front-line therapy with Venetoclax and Obinutuzumab (VenObi) in terms of rate of patients with uMRD by flow-cytometry in the PB and BM measured at the end of combination therapy (EOCT month 9)., The benefit of treatment with VenObi+Ven in terms of rate of patients with uMRD, L-MRD and H-MRD in the PB and BM at month 15, 21, 27, 33, 36 by: a. ASO-PCR b. Flow-cytometry, The benefit of treatment with VenObi+VenZan in terms of rate of patients with uMRD, L-MRD and H-MRD in the PB and BM at month 15, 21, 27, 33, 36 by: a. ASO-PCR b. Flow-cytometry 4. Rate of patients with uMRD according to the clinical and the biologic characteristics of CLL, Rate of patients with uMRD according to the clinical and the biologic characteristics of CLL, Progression Free Survival (PFS) at 36 months, Overall Survival (OS) at 36 months, Survival outcomes (OS and PFS) estimates at 36 months according to the: a. levels of MRD (uMRD, L-MRD, H-MRD); b. response (CR, PR, stable disease); c. treatment (Ven-Obi+Ven or VenObi+VenZan); d. the clinical and the biologic characteristics of CLL (CD38, CD49d, IGHV, FISH profile, mutations of TP53, NOTCH1, BIRC3, SF3B1), The benefit of treatment with VenObi+Ven or VenObi+VenZan on the improvement of Hb value, granulocyte, and platelet counts and immunoglobulin levels., The toxicity profile of treatment in terms of AE/SAE.

Source: https://euclinicaltrials.eu/ctis-public/view/2023-510431-11-00